EU clinical trial 2024-517489-41-00: IROCAS : A Phase III, Randomised, international trial comparing mFOLFIRINOX triplet chemotherapy to mFOLFOX for highrisk stage III colon cancer in adjuvant setting
Protocol code: UC-0110/1609
Sponsor: Unicancer (Hospital/Clinic/Other health care facility). Phase: Therapeutic confirmatory (Phase III). Countries: France (ongoing, recruitment ended), Italy (ongoing, recruitment ended).
Therapeutic area(s): Diseases [C] - Neoplasms [C04]
Gender: Female, Male. Age: 18-64 years, 65+ years. Enrolment: 66.
Status: Ongoing, recruitment ended. Start date (EU): 2017-03-27. Decision date: 2024-10-10. Results received: No. Last updated: 2024-10-15.
Decision dates by country: FR: 2024-10-10, IT: 2024-10-15

Condition(s): High-risk stage III colon cancer
Product: OXALIPLATIN, FOLINIC ACID, IRINOTECAN, FLUOROURACIL

Primary endpoint: The primary end-point is the Disease Free Survival (DFS) at 3 years, defined as the time from the date of randomization up to the date of: - first local, regional or distant relapse; - second colorectal cancer; - death from any cause included treatment-related death. Other primary cancer (except second primary colorectal) will be ignored.
Endpoint(s): Evaluation of Efficacy: The evaluation of efficacy is defined as the Disease Free Survival at 2 years, defined as the time from the date of randomization up to the date of: - first local, regional or distant relapse - second colorectal cancer - death from any cause included treatment-related death. Other primary cancer (except second primary colorectal) will be ignored., Overall Survival (OS): Overall Survival (OS) is defined as the time from the date of randomization to the date of documented death from any cause., Evaluation of Toxicity: Safety of the study treatment will be assessed on occurrence of Adverse Events (AEs), intake of concomitant treatments, per-treatment arising changes in physical examination, vital signs (blood pressure, pulse rate and body temperature), ECG, and clinical laboratory tests (biochemistry, haematology). Safety parameters will be graded based on NCI CTCAE v4.03 classification.

Source: https://euclinicaltrials.eu/ctis-public/view/2024-517489-41-00